EU clinical trial 2023-503698-40-00: Aspirin versus placebo in twin pregnancies for preeclampsia prevention: A multicentre, randomised, double-blind, placebo-controlled trial (ASPRE-T)
Protocol code: FFIS/2019/01/AS
Sponsor: Fundacion Para La Formacion E Investigacion Sanitaria De La Region De Murcia (Educational Institution). Phase: Therapeutic confirmatory (Phase III). Countries: Spain (ongoing, recruiting), Belgium (ongoing, recruiting), Poland (not authorised), Austria (ongoing, recruiting), Czechia (ongoing, recruiting), Denmark (ongoing, recruiting), Bulgaria (ongoing, recruiting), Greece (ongoing, recruiting), Germany (not authorised).
Therapeutic area(s): Diseases [C] - Female Urogenital Diseases and Pregnancy Complications [C13]
Gender: Female. Age: 18-64 years. Enrolment: 1298.
Start date (EU): 2023-03-23. Decision date: 2023-03-09. Results received: No. Last updated: 2026-07-17.
Decision dates by country: CZ: 2024-04-29, GR: 2025-08-26, BE: 2023-08-29, BG: 2025-08-29, ES: 2023-03-09, AT: 2024-04-08, DK: 2024-12-02

Condition(s): Preeclampsia
Product: Aspirin 75mg Gastro-resistant Tablets, Prosolv ® Easytab SR (JRS Pharma) & Acryl-EZE Aqueous Enteric coating solution (Colorcon) will be used in the manufacture of the placebo finished product.

Primary endpoint: To determine if the prophylactic use of low-dose aspirin from the first-trimester of pregnancy in women with twin pregnancy can reduce the incidence of PE with delivery <37 weeks’ gestation.
Endpoint(s): To determine the effect of low-dose aspirin on the incidence of (stratified according to chorionicity): Delivery with PE at <32 weeks, <34 weeks, <37 weeks and at any gestation., Gestational hypertension (GH), Birth at <32 weeks, <34 weeks and <37 weeks (Spontaneous, Iatrogenic for PE, GH or FGR, Iatrogenic for other reason)., Death of one twin and / or both twins before discharge from hospital: Miscarriage of the whole pregnancy or death of one twin <24 weeks’ gestation, Stillbirth or neonatal death of one or both twins at <32 weeks, <34 weeks, <37 weeks and at any gestation., Birthweight <3rd, <5th and <10th percentile for gestational age, Placental abruption (clinically or on placental examination) at <32 weeks, <34 weeks, <37 weeks and at any gestation., Postpartum hemorrhage (defined as blood loss ≥1 L within the first 24 hours after birth), Neonatal morbidity: Intraventricular hemorrhage (IVH) grade II or above : Grade II – IVH occupies <50% of the lateral ventricle volume. Grade III – IVH occupies ≥50% of the lateral ventricle volume. Grade IV – Hemorrhagic infarction in periventricular white matter ipsilateral to a large IVH. Neonatal sepsis. Encephalopathy grade. Neonatal seizures. Anemia. Respiratory distress. Necrotizing enterocolitis requiring surgical intervention. Composite of any of the above., Neonatal therapy: Neonatal intensive care unit admission, Ventilation defined as need of positive pressure (continuous positive airway pressure (CPAP) or nasal continuous positive airway pressure (NCPAP) or intubation, Length of stay in neonatal intensive care unit o composite of any of the above, Features of severe PE including: Stroke, Eclampsia, systolic blood pressure >160 mmHg on at least one occasion, diastolic blood pressure >110 mmHg on at least one occasion, respiratory failure requiring intubation or mechanical ventilation, myocardial ischemia or infarction, pulmonary edema, hepatic dysfuncion, hepatic hematoma or rapture, platelet count <100 x 109/litre, Features of severe PE including: abnormal liver function enzymes (ALT or AST >67 iu/litre), acute kidney injury, creatinine >150 μmol/L, cortical blindness, retinal detachment, transfusion of any blood products, HELLP syndrome, placental abruption, postpartum hemorrhage (defined as blood loss ≥1 L within the first 24 hours after birth), intensive therapy or high-dependency unit admission., Features of severe PE including: confirmed sepsis (positive blood or urine cultures) up to post-natal discharge, total number of nights in hospital.

Source: https://euclinicaltrials.eu/ctis-public/view/2023-503698-40-00